EU clinical trial 2024-510767-30-00: SGM-CBM: A feasibility study of SGM-101, a fluorochrome-labeled anti-carcinoembryonic antigen monoclonal antibody for the intraoperative detection of colorectal brain metastases.
Protocol code: NL74956.058.21
Sponsor: Academisch Ziekenhuis Leiden (Hospital/Clinic/Other health care facility). Phase: Therapeutic exploratory (Phase II). Countries: Netherlands (ended).
Therapeutic area(s): Diseases [C] - Neoplasms [C04]; Analytical,Diagnostic,Therapeutic Techniques and Equipment [E]-Surgical Procedures, Operative [E04]
Gender: Female, Male. Age: 18-64 years, 65+ years. Enrolment: 10.
Status: Ended. Start date (EU): 2023-12-04. End date (EU): 2025-06-11. Decision date: 2024-10-16. Results received: No. Last updated: 2024-10-16.

Condition(s): Brain metastases
Product: SGM-101

Primary endpoint: Based upon the primary objective: “To assess the performance of SGM-101 in the intraoperative detection of brain metastases of colorectal origin” we propose the following primary endpoint: Concordance rate between the pathology results with respect to the presence of cancer and the imaging assessment. This endpoint is chosen as this study serves as a proof of principle.
Endpoint(s): Concordance between intraoperative fluorescence assessment of resected lesions and their histopathology in terms of both CEA expression and tumor status., Modification of operative plan due to imaging (e.g. extension, reduction of resection margins, or additional resection) and change in postoperative treatment will be recorded., Tumor to background ratio (TBR) for fluorescence in malignant and benign tissue., - Treatment-emergent (serious) adverse events ((S)AEs). - Concomitant medication - Vital signs o Pulse Rate (bpm) o Systolic blood pressure (mmHg) o Diastolic blood pressure (mmHg) o Body temperature o Glasgow Coma Scale o Monitoring of unpredicted seizures o Monitoring of unpredicted focal deficits

Source: https://euclinicaltrials.eu/ctis-public/view/2024-510767-30-00